EU clinical trial 2025-523259-72-00: A double-blind, double-dummy, parallel group, multicenter Phase 3 extension study evaluating the long-term safety and efficacy of 2 doses of remibrutinib in adult participants with moderate to severe hidradenitis suppurativa
Protocol code: CLOU064J12303B
Sponsor: Novartis Pharma AG (Pharmaceutical company). Phase: Therapeutic confirmatory (Phase III). Countries: Portugal (authorised, recruitment pending), Greece (authorised, recruitment pending), Germany (authorised, recruitment pending), Hungary (authorised, recruitment pending), France (authorised, recruitment pending), Spain (authorised, recruitment pending), Bulgaria (authorised, recruitment pending), Slovakia (authorised, recruitment pending), Poland (authorised, recruitment pending), Czechia (authorised, recruitment pending), Belgium (authorised, recruitment pending), Italy (authorised, recruitment pending).
Therapeutic area(s): Diseases [C] - Immune System Diseases [C20]
Gender: Female, Male. Age: 18-64 years, 65+ years. Enrolment: 307.
Status: Authorised, recruitment pending. Decision date: 2026-05-20. Results received: No. Last updated: 2026-07-27.
Decision dates by country: ES: 2026-06-01, SK: 2026-05-20, BE: 2026-05-20, BG: 2026-05-22, CZ: 2026-05-21, FR: 2026-05-20, DE: 2026-05-21, GR: 2026-05-21, HU: 2026-05-28, IT: 2026-05-25, PL: 2026-05-25, PT: 2026-05-21

Condition(s): Hidradenitis Suppurativa (HS)
Product: Placebo to Remibrutinib (LOU064) XX mg film-coated tablet, Placebo to Remibrutinib (LOU064) XX mg film-coated tablet, LOU064, LOU064

Primary endpoint: Occurrence of treatment-emergent Adverse Events (TEAEs)
Endpoint(s): • Achievement of AN50/75/90. • Percentage change from baseline in IHS4 • Achievement of HiSCR50/75/90. • Achievement of NRS30 among participants with baseline NRS ≥ 3 (in the main studies).

Source: https://euclinicaltrials.eu/ctis-public/view/2025-523259-72-00